EU clinical trial 2023-509707-32-00: Pembrolizumab for locally advanced, irresectable, non-metastatic dMMR colorectal cancers. The PUMA study.
Sponsor: Het Nederlands Kanker Instituut-Antoni van Leeuwenhoek Ziekenhuis Stichting (Hospital/Clinic/Other health care facility). Phase: Therapeutic exploratory (Phase II). Countries: Netherlands (ongoing, recruitment ended).
Therapeutic area(s): Diseases [C] - Neoplasms [C04]
Gender: Female, Male. Age: 18-64 years, 65+ years. Enrolment: 25.
Status: Ongoing, recruitment ended. Start date (EU): 2022-12-13. Decision date: 2024-02-21. Results received: No. Last updated: 2025-12-01.

Condition(s): Locally advanced, irresectable dMMR colorectal cancers
Product: KEYTRUDA 25 mg/mL concentrate for solution for infusion

Primary endpoint: To determine the objective response rate (ORR) according to RECIST 1.1 and iRECIST criteria in order to assess the efficacy of pembrolizumab in patients with locally advanced, irresectable dMMR colorectal cancers
Endpoint(s): To assess the major pathological response (MPR, ≤10% viable tumor rest) in patients undergoing surgery, To find biomarkers and evaluation strategies able to accurately assess complete and near-complete responses in order to pursue organ-sparing treatment (omission of surgery) in this patient population; Post-treatment CT-scans: can we use radiomics to accurately assess complete and near-complete response?; ctDNA analysis: can we use ctDNA to assess complete response and is there a difference between complete and near-complete response in terms of minimal residual disease on ctDNA and relapse?, To perform translational analyses, yet to be determined, which may include the following: RNA sequencing and inflammatory signatures to validate current findings and identify predictors of response; Analysis of immune cell infiltration and differences between responders and non-responders; Immunogenic mutational load by tumor tissue DNA WES. Peripheral blood DNA WES as a control for somatic mutation sorting, Date of relapse, as determined by disease recurrence or disease-related death during follow-up after surgery. Follow-up will be performed according to local and/or national guidelines, Association between microbiota composition and treatment outcomes and the effect of neoadjuvant pembrolizumab on the gut microbiota composition

Source: https://euclinicaltrials.eu/ctis-public/view/2023-509707-32-00